EU clinical trial 2023-505189-26-00: A Phase 1/2 Open-Label, Umbrella Platform Design Study of Investigational Agents With or Without Pembrolizumab (MK‑3475) and/or Chemotherapy in Participants With Advanced Esophageal Cancer Previously Exposed to PD-1/PD-L1 Treatment (KEYMAKER-U06): Substudy 06B
Protocol code: MK-3475-06B
Sponsor: Merck Sharp & Dohme LLC (Pharmaceutical company). Phase: Phase I and Phase II (Integrated)- Other. Countries: Norway (ongoing, recruiting), Germany (ongoing, recruiting), Italy (ongoing, recruiting).
Therapeutic area(s): Diseases [C] - Neoplasms [C04]
Gender: Female, Male. Age: 18-64 years, 65+ years. Enrolment: 10.
Status: Ongoing, recruiting. Start date (EU): 2023-03-28. Decision date: 2024-06-24. Results received: No. Last updated: 2026-06-12.
Decision dates by country: DE: 2024-07-01, NO: 2024-06-24, IT: 2024-08-29

Condition(s): Advanced esophageal squamous cell carcinoma
Product: Lenvatinib, MK-2870, PACLITAXEL, FAMOTIDINE, PARACETAMOL, MK-2870, Lenvatinib, IRINOTECAN, KEYTRUDA 25 mg/mL concentrate for solution for infusion, MK-4830

Primary endpoint: Number of Participants Experiencing Dose-limiting Toxicities (DLTs) During Safety Lead-in Phase, Number of Participants Who Experienced an Adverse Event (AE) During Safety Lead-in Phase, Number of Participants Who Discontinue Study Treatment Due to an AE During Safety Lead-in Phase, Objective Response Rate (ORR)
Endpoint(s): Progression-Free Survival (PFS), Duration of Response (DOR), Overall Survival (OS), Number of Participants Experiencing at Least One Adverse Event (AE) During the Efficacy Phase, Number of Participants Who Discontinue Study Treatment Due to An AE During the Efficacy Phase

Source: https://euclinicaltrials.eu/ctis-public/view/2023-505189-26-00